EU clinical trial 2025-522703-14-00: A Phase 3 Randomized, Double-blind, Placebo-controlled Study to Evaluate the Efficacy, Safety, and Tolerability of Maridebart Cafraglutide in Adult Participants with Obstructive Sleep Apnea on Positive Airway Pressure Therapy and Living with Overweight or Obesity (MARITIME-OSA-1)
Protocol code: 20230225
Sponsor: Amgen Inc. (Pharmaceutical company). Phase: Therapeutic confirmatory (Phase III). Countries: Poland (ongoing, recruiting), Germany (ongoing, recruiting), Czechia (ongoing, recruiting), Hungary (ongoing, recruiting), Spain (ongoing, recruiting), France (ongoing, recruiting).
Therapeutic area(s): Diseases [C] - Respiratory Tract Diseases [C08]
Gender: Female, Male. Age: 18-64 years, 65+ years. Enrolment: 115.
Status: Ongoing, recruiting. Start date (EU): 2026-02-17. Decision date: 2026-02-10. Results received: No. Last updated: 2026-02-24.
Decision dates by country: CZ: 2026-02-10, DE: 2026-02-10, HU: 2026-02-13, ES: 2026-02-12, PL: 2026-02-16, FR: 2026-02-24

Condition(s): "Moderate to severe obstructive sleep apnea (OSA) in adults living with overweight or obesity"
Product: AMG 133, Placebo for AMG 133, AMG 133, AMG 133

Primary endpoint: Change in AHI from baseline at week 52
Endpoint(s): "- Percent change in AHI from baseline at week 52 - Achieving ≥ 50% AHI reduction from baseline at week 52 - Achieving AHI < 5 or AHI 5 to 14 with Epworth Sleepiness Scale (ESS) ≤10 at week 52 - Change in Sleep Apnea-specific Hypoxic burden (%/min/hour) from baseline at week 52", "- Percent change in body weight from baseline at week 52 - Change in high sensitivity C-reactive protein (hs-CRP) from baseline at week 52 - Change in SBP (mmHg) from baseline at - Change in Patient-Reported Outcomes Measurement Information System (PROMIS) Short Form v1.0 Sleep-Related Impairment 8a score from baseline at week 52"

Source: https://euclinicaltrials.eu/ctis-public/view/2025-522703-14-00